EU clinical trial 2023-508233-14-00: Whole body HER3 quantification with radiolabelled Patritumab deruxtecan (HER3-DXd) PET/CT
Protocol code: U31402-0002-CESR-MA
Sponsor: Het Nederlands Kanker Instituut-Antoni van Leeuwenhoek Ziekenhuis Stichting (Hospital/Clinic/Other health care facility). Phase: Therapeutic exploratory (Phase II). Countries: Netherlands (ongoing, recruiting).
Therapeutic area(s): Diseases [C] - Pathological Conditions, Signs and Symptoms [C23]; Diseases [C] - Respiratory Tract Diseases [C08]
Gender: Female, Male. Age: 18-64 years, 65+ years. Enrolment: 16.
Status: Ongoing, recruiting. Start date (EU): 2025-03-03. Decision date: 2024-07-15. Results received: No. Last updated: 2026-04-21.

Condition(s): EGFR mutation positive advanced stage NSCLC
Product: Patritumab Deruxtecan, ZIRCONIUM (89Zr) Patritumab Deruxtecan

Primary endpoint: The optimal imaging dose patritumab deruxtecan to co-inject with 89Zr-Patritumab deruxtecan (HER3-DXd), defined by adequate visualisation of the circulation five days after tracer injection.
Endpoint(s): SUV of tumor lesions.

Source: https://euclinicaltrials.eu/ctis-public/view/2023-508233-14-00